EU clinical trial 2024-518641-21-00: The effect of liraglutide on MMC activity, gastrointestinal hormones, hunger ratings and ad libitum food intake in healthy volunteers.
Sponsor: UZ Leuven (Hospital/Clinic/Other health care facility). Phase: Therapeutic use (Phase IV). Countries: Belgium (ongoing, recruiting).
Therapeutic area(s): Diseases [C] - Nutritional and Metabolic Diseases [C18]
Gender: Female, Male. Age: 18-64 years. Enrolment: 15.
Status: Ongoing, recruiting. Start date (EU): 2020-02-07. Decision date: 2024-12-18. Results received: No. Last updated: 2024-12-18.

Condition(s): Obesity
Product: SALINE, Victoza 6 mg/ml solution for injection in pre-filled pen

Primary endpoint: To detect changes in MMC activity after the administration of liraglutide compared to placebo.
Endpoint(s): A difference in gastrointestinal hormone release compared between placebo and liraglutide treatment, A difference in hunger sensations compared between placebo and liraglutide treatment, A difference in ad libitum food intake compared between placebo and liraglutide treatment, A difference in whole blood glucose levels compared between placebo and liraglutide treatment

Source: https://euclinicaltrials.eu/ctis-public/view/2024-518641-21-00